EU clinical trial 2023-504311-32-00: A Phase I/II study of Bosutinib in pediatric patients with newly diagnosed chronic phase or resistant/intolerant Ph+ Chronic Myeloid Leukemia, study ITCC-054/COG AAML1921
Protocol code: ITCC-054/AAML1921
Sponsor: Erasmus Universitair Medisch Centrum Rotterdam (Erasmus MC) (Hospital/Clinic/Other health care facility). Phase: Phase I and Phase II (Integrated)- Other. Countries: France (ongoing, recruitment ended), Germany (ongoing, recruitment ended), Spain (ongoing, recruitment ended), Netherlands (ongoing, recruitment ended), Italy (ongoing, recruitment ended).
Therapeutic area(s): Diseases [C] - Neoplasms [C04]
Gender: Female, Male. Age: 0-17 years. Enrolment: 30.
Status: Ongoing, recruitment ended. Start date (EU): 2016-09-02. Decision date: 2024-02-07. Results received: No. Last updated: 2025-12-09.
Decision dates by country: FR: 2024-02-26, IT: 2024-02-12, DE: 2024-02-09, NL: 2024-02-07, ES: 2024-02-08

Condition(s): Chronic Myeloid Leukemia
Product: Bosutinib, Bosutinib, Bosulif 100 mg film-coated tablets, Bosulif 500 mg film-coated tablets, Bosulif 100 mg film-coated tablets, Bosulif 100 mg film-coated tablets, Bosulif 500 mg film-coated tablets

Primary endpoint: Phase 1: Incidence and severity of Dose-Limiting Toxicities (DLTs) assessed during the first 28 days of treatment., Phase 1: PK parameters of bosutinib: Maximum observed plasma concentration (Cmax), time to Cmax (Tmax), area under the plasma concentration versus time curve from time zero to the dosing interval (AUCτ), pre-dose concentration (Ctrough) and apparent clearance (CL/F)., Phase 2: AEs, as characterized by type, frequency, severity (as graded using CTCAE version, v4.03), timing, seriousness, and relation to study therapy (pooled across ND and R/I CML patients and by line of therapy)., Phase 2: PK parameters of bosutinib: Maximum observed plasma concentration (Cmax), time to Cmax (Tmax), area under the plasma concentration versus time curve from time zero the dosing interval (AUCτ), predose concentration (Ctrough) and apparent clearance CL/F., Phase 2: Population PK parameters of bosutinib including clearance and volume of distribution based on combined PK data from Phase 1 and Phase 2.
Endpoint(s): Phase 1: AEs, as characterized by type, frequency, severity (as graded using CTCAE version, v4.03), timing, seriousness, and relation to study therapy;, Phase 1: Laboratory abnormalities as characterized by type, frequency, severity and timing;, Phase 1: ECG and performance status abnormalities, Phase 1: Overall cumulative disease response: complete hematologic response (CHR), major cytogenetic response (MCyR, defined as complete cytogenetic response [CCyR] plus partial cytogenetic response [PCyR]), CCyR, major molecular response (MMR) and deep molecular response., Phase 2: Overall cumulative disease response by the line of therapy: complete hematologic response (CHR), major cytogenetic response (MCyR, defined as complete cytogenetic response [CCyR] plus partial cytogenetic response [PCyR]), CCyR, major molecular response (MMR) and deep molecular response., Phase 2: Time to and duration of the respective responses by line of therapy., Phase 2: Event-free survival (EFS; including time to transformation to AP and BP CML) by line of therapy., Phase 2: Overall survival (OS) in pediatric patients with Ph+ CML by line of therapy., Phase 2: Laboratory abnormalities as characterized by type, frequency, severity and timing (pooled across ND and R/I CML and by line of therapy)., Phase 2: ECG and performance status abnormalities., Phase 2: Relationships between PK parameters of bosutinib and key safety and efficacy metrics.

Source: https://euclinicaltrials.eu/ctis-public/view/2023-504311-32-00